EU clinical trial 2023-506559-10-00: Randomised, bioequivalence clinical trial of ezetimibe/atorvastatin 10 mg/80 mg tablets versus ezetimibe/atorvastatin 10 mg/80 mg film-coated tablets, after a single oral dose administration to healthy volunteers under fasting conditions in crossover replicated design.
Protocol code: N-EZEATO-23-280
Sponsor: Laboratorios Normon S.A. (Pharmaceutical company). Phase: Human Pharmacology (Phase I)- Bioequivalence Study. Countries: Spain (ended).
Therapeutic area(s): Not possible to specify
Gender: Female, Male. Age: 18-64 years. Enrolment: 36.
Status: Ended. Start date (EU): 2023-09-07. End date (EU): 2023-11-07. Decision date: 2023-09-06. Results received: Yes. Last updated: 2023-09-06.

Condition(s): Healthy volunteers
Product: Ezetimiba/Atorvastatina Normogen 10 mg/80 mg comprimidos, ATOZET 10 mg/80 mg comprimidos recubiertos con película

Primary endpoint: Atorvastatin AUC0-t, Atorvastatin Cmax, Total ezetimibe AUC0-72, Total ezetimibe Cmax
Endpoint(s): Atorvastatin AUC0-∞, Atorvastatin Tmax, Atorvastatin residual area, Total ezetimibe Tmax

Source: https://euclinicaltrials.eu/ctis-public/view/2023-506559-10-00